EU clinical trial 2024-516802-43-00: A Phase 1b/2 study of arfolitixorin as part of 5-fluorouracil-based treatment regimens in the first-line treatment of metastatic colorectal cancer
Protocol code: ISO-CC-010
Sponsor: Isofol Medical AB (publ) (Pharmaceutical company). Phase: Phase I and Phase II (Integrated)- Other. Countries: Germany (ongoing, recruiting).
Therapeutic area(s): Diseases [C] - Neoplasms [C04]
Gender: Female, Male. Age: 18-64 years, 65+ years. Enrolment: 90.
Status: Ongoing, recruiting. Start date (EU): 2025-04-09. Decision date: 2024-12-23. Results received: No. Last updated: 2026-08-04.

Condition(s): metastatic colorectal cancer
Product: Arfolitixorin, CALCIUM FOLINATE

Primary endpoint: Phase 1b: Number and severity of AEs, including clinically significant abnormal laboratory findings, regardless of causal relationship to ARFOX + bevacizumab. The outcome of Phase 1b is to determine the MTD of arfolitixorin (ARFOX + bevacizumab) in patients with mCRC., Phase 2: ORR, defined as the proportion of patients who have BOR of CR, or PR, measured from the start of the study treatment until the EOT by RECIST (version 1.1)., Phase 2: Number and severity of AEs, including clinically significant abnormal laboratory findings, regardless of causal relationship to given treatment., Phase 2: DOR, defined as the duration of CR or PR.
Endpoint(s): Phase 1b: ORR, defined as the proportion of patients who have BOR of CR, or PR, measured from the start of the study treatment until the EOT by RECIST (version 1.1)., Phase 1b and Phase 2: PFS, defined as the time from date of the first study dose to the date of first documentation of confirmed disease progression or death (whichever occurs first)., Phase 1b and Phase 2: OS, measured from the date of study treatment initiation to the date of death., Phase 1b: Plasma concentration of arfolitixorin., Phase 2: TTR, defined as the time from the first study dose date to the date of first documentation of CR or PR measured by RECIST (version 1.1)., Phase 2: DCR, defined as the proportion of patients who have BOR of CR, PR, or SD ≥8 weeks., Phase 2: DpR, defined as the maximum percentage change in tumor size compared with baseline., Phase 2: OS, measured from the date of study treatment initiation to the date of death., Phase 2: Proportion of patients qualifying for curative metastasis resection after treatment with study drug.

Source: https://euclinicaltrials.eu/ctis-public/view/2024-516802-43-00